EU clinical trial 2024-518400-50-00: PRE-emptive DAratumumab Therapy Of minimal Residual disease reappearance or biochemical relapse in multiple myeloma (PREDATOR).
Protocol code: PMC008
Sponsor: Polish Myeloma Consortium (Patient organisation/association). Phase: Therapeutic exploratory (Phase II). Countries: Poland (ended).
Therapeutic area(s): Diseases [C] - Neoplasms [C04]
Gender: Female, Male. Age: 18-64 years, 65+ years. Enrolment: 274.
Status: Ended. Start date (EU): 2018-11-14. End date (EU): 2025-11-26. Decision date: 2024-12-02. Results received: No. Last updated: 2025-12-05.

Condition(s): Multiple Myeloma and Minimal Residual Disease
Product: DARZALEX 1800 mg solution for injection

Primary endpoint: To compare (EFS) between daratumumab arm and observation arm after randomization of patients with biochemical relapse of MM. To compare (EFS) between daratumumab arm and observation arm after randomization of patients with reappearance of MRD in MM.
Endpoint(s): SPR, CRAB or death. Overall response rate (ORR) as determined by Investigator evaluation, defined as the percentage of subjects achieving an objective response (i.e., partial response or better), using the IMWG Consensus Panel 1 response criteria.

Source: https://euclinicaltrials.eu/ctis-public/view/2024-518400-50-00